EU clinical trial 2023-505576-29-00: A Phase 1/2a, First in Human, Open-Label, Multicenter, Dose Escalation Study with Expansion Cohorts to Evaluate the Safety, Tolerability, and Preliminary Activity of LB101 in Subjects with Advanced Solid Tumors
Protocol code: LB101-101
Sponsor: Centessa Pharmaceuticals UK Limited (Pharmaceutical company). Phase: Phase I and Phase II (Integrated)- First administration to humans. Countries: France (ended).
Therapeutic area(s): Diseases [C] - Neoplasms [C04]
Gender: Female, Male. Age: 18-64 years, 65+ years. Enrolment: 6.
Status: Ended. Start date (EU): 2024-01-03. End date (EU): 2024-11-21. End date: 2025-09-09. Decision date: 2023-11-20. Results received: No. Last updated: 2024-07-15.

Condition(s): Advanced solid tumors

Source: https://euclinicaltrials.eu/ctis-public/view/2023-505576-29-00